EU clinical trial 2024-511285-37-00: An open-label study to provide berotralstat access to subjects with type I and II hereditary angioedema who were previously enrolled in berotralstat studies
Protocol code: BCX7353-312
Sponsor: Biocryst Pharmaceuticals Inc. (Pharmaceutical company). Phase: Phase III and phase IV (Integrated). Countries: Poland (ongoing, recruitment ended), Slovakia (ongoing, recruitment ended), Czechia (ongoing, recruitment ended), Spain (ongoing, recruitment ended), Germany (ongoing, recruiting), France (authorised, recruitment pending), Italy (ended).
Therapeutic area(s): Diseases [C] - Hemic and Lymphatic Diseases [C15]
Gender: Female, Male. Age: 0-17 years, 18-64 years, 65+ years. Enrolment: 45.
Start date (EU): 2021-08-31. Decision date: 2024-07-17. Results received: No. Last updated: 2026-07-20.
Decision dates by country: CZ: 2024-07-17, SK: 2024-07-19, IT: 2025-10-22, DE: 2025-09-01, FR: 2025-09-04, PL: 2024-07-17, ES: 2025-09-16

Condition(s): Hereditary Angioedema
Product: Berotralstat, BEROTRALSTAT, Berotralstat, Berotralstat, Berotralstat

Primary endpoint: Number and proportion of subjects with a treatment-related TEAE, Number and proportion of subjects who experience a serious adverse event (SAE), Number and proportion of subjects who experience a treatment-related Grade 3 or 4 TEAE, Number and proportion of subjects who experience a treatment-related Grade 3 or 4 treatment-emergent chemistry abnormality, Number and proportion of subjects who discontinue due to a TEAE
Endpoint(s): Another mechanism is available to provide drug to the subject(eg, market access), or until the sponsor discontinues all global commercialization and development of berotralstat for the prevention of angioedema attacks, whichever comes first

Source: https://euclinicaltrials.eu/ctis-public/view/2024-511285-37-00